EU clinical trial 2024-511889-36-01: A PHASE III OPEN LABEL STUDY CONTROLLED BY VITAMIN D3 SUPPLEMENTATION AND THE DIFFERENCES BETWEEN YOUNG ADULTS AND SENIOR POPULATION
Protocol code: D3-2024
Sponsor: Fakultni Nemocnice Plzen (Hospital/Clinic/Other health care facility). Phase: Therapeutic confirmatory (Phase III). Countries: Czechia (not authorised).
Therapeutic area(s): Diseases [C] - Immune System Diseases [C20]
Gender: Female, Male. Age: 18-64 years, 65+ years. Enrolment: 150.
Status: Not authorised. Decision date: 2024-10-25. Results received: No. Last updated: 2024-10-25.

Condition(s): Healthy population
Product: Vigantol 0,5 mg/ml perorální kapky, roztok

Primary endpoint: Primary e nd point is Serum 25 hydroxycholecalciferol.
Endpoint(s): Secondary e nd p oints are Serum 24,25 dihydroxycholecalciferol levels and Serum 3 epi 25 hydroxycholecalciferol levels.

Source: https://euclinicaltrials.eu/ctis-public/view/2024-511889-36-01